EU clinical trial 2023-504945-30-00: Adjuvant instillations in intermediate risk NMIBC: A Study comparIng Gemcitabine and MitomYciN (SIGYN-trial)
Sponsor: Region Skane (Hospital/Clinic/Other health care facility). Phase: Therapeutic confirmatory (Phase III). Countries: Sweden (ongoing, recruitment ended).
Therapeutic area(s): Diseases [C] - Neoplasms [C04]
Gender: Female, Male. Age: 18-64 years, 65+ years. Enrolment: 340.
Status: Ongoing, recruitment ended. Start date (EU): 2021-03-16. Decision date: 2024-08-30. Results received: No. Last updated: 2024-08-30.

Condition(s): Primary or recurrent non-muscle invasive bladder cancer with intermediate risk of recurrence after transurethral tumour resection
Product: Mitomycin medac, 40 mg, pulver och vätska till intravesikal lösning, Gemcitabine Accord 100 mg/ml Koncentrat till infusionsvätska, lösning

Primary endpoint: Recurrence-free survival
Endpoint(s): Local toxicity and HRQol two weeks after last installation, Progression-free survival, Health economy, Adverse events

Source: https://euclinicaltrials.eu/ctis-public/view/2023-504945-30-00